EU clinical trial 2024-516431-27-00: Open label, Multicenter, Prospective Study to Characterize the Pharmacokinetics and Pharmacodynamics of Cufence (Trientine Dihydrochloride) and to Investigate the Efficacy and Safety in Wilson’s Disease Patients
Protocol code: TR-004
Sponsor: Univar Solutions B.V. (Pharmaceutical company). Phase: Therapeutic use (Phase IV). Countries: Germany (ended), France (ended), Denmark (ended), Poland (ended).
Therapeutic area(s): Diseases [C] - Nutritional and Metabolic Diseases [C18]
Gender: Female, Male. Age: 0-17 years, 18-64 years, 65+ years. Enrolment: 46.
Status: Ended. Start date (EU): 2021-02-23. End date (EU): 2025-09-19. End date: 2025-09-20. Decision date: 2024-09-11. Results received: Yes. Last updated: 2024-10-16.
Decision dates by country: DK: 2024-09-11, FR: 2024-09-17, DE: 2024-09-11, PL: 2024-10-16

Condition(s): Wilson’s Disease
Product: Cufence 200 mg hard capsules

Primary endpoint: Concentration of trientine in plasma, Trientine clearance (CL/F) and volume(s) of distribution (V/F), 24-hr UCE (copper marker), NCC (copper marker), Serum copper (copper marker), Serum ceruloplasmin (copper marker), Patient characteristics for covariates
Endpoint(s): Concentration of MAT in plasma, Concentration of DAT in plasma, AUC0-t, Cmax and Ctrough for trientine and metabolites. (As secondary endpoint, pre-dose concentrations are reported and summarized using NCA. While the pre-dose PK samples are collected shortly prior to the next dose, the pre-dose concentration is assumed to approximate the Ctrough.), Number of AEs including number of AEs leading to discontinuation of treatment with Cufence, Changes in neurological disease status (Unified Wilson’s Disease Rating Scale (UWDRS)), Changes in psychiatric symptoms (SCID-5, MMSE, EQ-5D-3L, PHQ-9, PHQ-9-A, CBCL), Changes in hepatic disease (full liver panel to determine the APRI, the Child-Pugh score, the FIB4 index and the New Wilson Index (Dhawan Index), and Fibroscan)

Source: https://euclinicaltrials.eu/ctis-public/view/2024-516431-27-00